EU clinical trial 2023-505145-93-00: A Phase I/II, Open-Label, Multi-Center Study of ALE.C04 (anti-Claudin-1 Antibody) as a Single Agent and in Combination with Pembrolizumab (anti-PD-1 antibody) in Adult Patients with Recurrent or Metastatic (R/M) Head and Neck Squamous Cell Carcinoma
Protocol code: ALE.C04.01
Sponsor: Alentis Therapeutics AG (Pharmaceutical company). Phase: Phase I and Phase II (Integrated)- First administration to humans. Countries: Italy (ended), Spain (ended), France (ended).
Therapeutic area(s): Diseases [C] - Neoplasms [C04]
Gender: Female, Male. Age: 18-64 years, 65+ years. Enrolment: 104.
Status: Ended. Start date (EU): 2024-03-21. End date (EU): 2025-02-11. End date: 2025-02-12. Decision date: 2023-12-01. Results received: Yes. Last updated: 2025-02-11.
Decision dates by country: FR: 2023-12-04, IT: 2023-12-01, ES: 2023-12-01

Condition(s): Recurrent or Metastatic (R/M) Head and Neck Squamous Cell Carcinoma
Product: ALE.C04, KEYTRUDA 25 mg/mL concentrate for solution for infusion

Primary endpoint: Incidence of DLTs, Incidence and severity of AEs, SAEs, Changes in laboratory values, vital signs, and ECGs, Tolerability: dose interruptions and dose intensity, To compare PFS per RECIST 1.1 by BICR, CLDN1 and PD-L1 subgroup analysis will be performed
Endpoint(s): Evaluated by investigators for both monotherapy and combination therapy: ORR, (ORR = CR rate + PR rate); iORR (iORR = iCR rate + iPR rate); DCR (DCR = CR rate + PR rate + SD rate); iDCR (iDCR=iCR rate + iPR rate + iSD rate); DOR and iDOR; PFS and iPFS (including rate at 6 and 12 months) per RECIST 1.1/iRECIST. Efficacy endpoints by BIRC in Phase II (randomized) CLDN1 and PD-L1 subgroup analysis will be performed., Overall Survival (OS) for both single agent and combination. Efficacy endpoints by BIRC in Phase II (randomized) CLDN1 and PD-L1 subgroup analysis will be performed, Serum concentrations of ALE.C04, PK parameters and exposure measures including, but not limited to, Cmax, Cmin, AUC, and other parameters as appropriate for ALE.C04, Pembrolizumab PK reported as concentration by time point, Measurement of anti-ALE.C04 antibodies and anti-pembrolizumab antibodies, eEORTC QLQ-C30 and EORTC QLQ-HN43

Source: https://euclinicaltrials.eu/ctis-public/view/2023-505145-93-00